EU clinical trial 2023-504728-24-00: Efficacy of melatonin, low-dose quetiapine, or placebo in patients with psychiatric disorders and comorbid insomnia: a randomized clinical trial
Sponsor: Region Hovedstadens Psykiatriske, Psykiatrisk Center Kobenhavn (Hospital/Clinic/Other health care facility). Phase: Phase II and Phase III (Integrated). Countries: Denmark (ongoing, recruiting).
Therapeutic area(s): Psychiatry and Psychology [F] - Mental Disorders [F03]
Gender: Female, Male. Age: 18-64 years. Enrolment: 255.
Status: Ongoing, recruiting. Start date (EU): 2023-09-15. Decision date: 2023-07-31. Results received: No. Last updated: 2026-06-17.

Condition(s): Psychiatric disorder (ICD-10 F20-F69, F84, F90-F95) and insomnia
Product: Melatonin Orifarm 3 mg filmdragerade tabletter, Quetiapin Sandoz 25 mg filmdrasjerte tabletter, Starch and Lactose containing gelatine capsules

Primary endpoint: Insomnia severity using the Insomnia Severity Index (ISI)
Endpoint(s): Clinical global impression (CGI), Subjective sleep quality using the Pittsburgh Sleep Quality Index (PSQI), Psychosocial functioning using the Personal and Social Performance Scale (PSP), Patient-reported subjective well-being using the WHO-5 well-being index

Source: https://euclinicaltrials.eu/ctis-public/view/2023-504728-24-00